EU clinical trial 2025-523146-27-00: Phase 1 clinical trial to evaluate the safety, tolerability, and pharmacokinetics of intravenous single ascending doses of IM-250 in healthy volunteers.
Protocol code: IM-104
Sponsor: Fuics Development Limited (Pharmaceutical company). Phase: Human Pharmacology (Phase I)- Other. Countries: Bulgaria (ongoing, recruiting).
Therapeutic area(s): Not possible to specify
Gender: Female, Male. Age: 18-64 years. Enrolment: 30.
Status: Ongoing, recruiting. Start date (EU): 2026-05-26. Decision date: 2025-11-18. Results received: No. Last updated: 2026-06-25.

Condition(s): Herpes simplex virus encephalitis

Source: https://euclinicaltrials.eu/ctis-public/view/2025-523146-27-00